EU clinical trial 2024-515630-33-00: A single dose of apixaban for the prevention of thrombotic events in the context of long-distance flights (DANCE FLIGHT)
Protocol code: 2023-01-1200-01
Sponsor: Klinikum der Universitaet Muenchen AöR (Hospital/Clinic/Other health care facility). Phase: Therapeutic confirmatory (Phase III). Countries: Germany (ended).
Therapeutic area(s): Diseases [C] - Pathological Conditions, Signs and Symptoms [C23]
Gender: Female, Male. Age: 18-64 years, 65+ years. Enrolment: 27698.
Status: Ended. End date (EU): 2025-11-12. Decision date: 2024-11-11. Results received: Yes. Last updated: 2025-05-19.

Condition(s): Symptomatic leg vein thrombosis
Product: Eliquis 2.5 mg film-coated tablets, Hard-gelantine capsule filled with Mannitol

Primary endpoint: The occurrence of clinically relevant leg vein thrombosis.
Endpoint(s): Occurrence of clinically relevant and non-relevant leg vein thromboses, Occurrence of any bleeding (BARC ≥ 1)

Source: https://euclinicaltrials.eu/ctis-public/view/2024-515630-33-00